EU clinical trial 2026-525770-19-00: Optimising the protocol of labour induction using misoprostol – randomised open-label clinical trial (OPTIMISO)
Protocol code: OPTIMISO-2026
Sponsor: Fakultni Nemocnice Brno (Hospital/Clinic/Other health care facility). Phase: Therapeutic use (Phase IV). Countries: Czechia (ongoing, recruiting).
Therapeutic area(s): Diseases [C] - Female Urogenital Diseases and Pregnancy Complications [C13]
Gender: Female. Age: 18-64 years. Enrolment: 200.
Status: Ongoing, recruiting. Start date (EU): 2026-07-15. Decision date: 2026-05-28. Results received: No. Last updated: 2026-06-01.
Decision dates by country: CZ: 2026-06-01

Condition(s): Labour induction
Product: Angusta 25 mikrogramů tablety

Primary endpoint: Reduction of total misoprostol dose in the concurrent arm vs. sequential arm
Endpoint(s): Number of misoprostol doses, Incidence of adverse events related to either misoprostol or osmotic dilator, Maternal outcomes (Incidence of uterine tachysystole, uterine rupture, perineal trauma grade III and IV, blood loss ≥1000 mL, infection complications (chorioamnionitis, endometritis), maternal mortality), Labour outcomes (Proportion of deliveries completed vaginally, vaginal extractions (VEX, forceps), CS, CS due to acute fetal hypoxia, CS due to failed induction of labour, manual lysis of the placenta, oxytocin i.v. use during labour, epidural analgesia use), Fetal/Neonatal outcomes (perinatal mortality, Apgar score in the 1st, 5th and 10th minute after birth, birth weight, pH and base excess (BE) from the umbilical artery, incidence of infectious complications (sepsis, fever, infection proved by microbiological examination, clinical status requiring systemic antibiotics), neonatal seizures during 24 hours after birth, proportion of neonates admitted to the NICU during the first 24 hours after birth, neonatal mortality), Duration of labour induction (time from induction start to the onset of the first stage of labour), first stage of labour, second stage of labour, time from induction start to the birth of the child, time from admission to discharge of the participant, Rate of successful induction in the first induction attempt, proportion of patients in need of induction retrial, rate of successful induction in the second induction attempt, rate of failed induction of labour

Source: https://euclinicaltrials.eu/ctis-public/view/2026-525770-19-00